EU clinical trial 2025-521533-85-00: A Randomized, Parallel, Open-Label, Phase 1/2a Study to Assess the Safety and Tolerability of Multiple Doses of the Bacteriophage Cocktail TP-122 (Component TP-122A), for the Treatment of Ventilator-Associated Pneumonia
Protocol code: TP-122_101A
Sponsor: Technophage Investigacao E Desenvolvimento Em Biotecnologia S.A. (Pharmaceutical company). Phase: Phase I and Phase II (Integrated)- First administration to humans. Countries: Portugal (suspended), Netherlands (authorised, recruitment pending).
Therapeutic area(s): Diseases [C] - Bacterial Infections and Mycoses [C01]; Diseases [C] - Respiratory Tract Diseases [C08]
Gender: Female, Male. Age: 18-64 years, 65+ years. Enrolment: 38.
Decision date: 2025-09-09. Results received: No. Last updated: 2026-04-09.
Decision dates by country: NL: 2025-09-09, PT: 2025-09-09

Condition(s): Ventilator-Associated Pneumonia
Product: TP-122, Excipient mixture (solvent):Sodium Chloride 0.9% w/v ;Tromethamine TRIS® 0.30% w/v; Polysorbate 80 0.02% w/v; Glycerol 5% v/v; Mannitol 0.6% w/v; Hydrochloric Acid q.s.

Primary endpoint: Analysis of TP-122A arm with SoC versus SoC alone, and individual analysis per treatment arm of the following assessments: Adverse Events (AEs), Clinical laboratory parameters, Vital signs, Eletrocardiogram (ECG)
Endpoint(s): Proportion of subjects achieving “Clinical Cure” (CR), Time to achieve “Clinical Cure”., Proportion of subjects achieving Microbiological Response (MR) of “Eradication” or “Presumed Eradication” of TP-122A target bacteria, Time to achieve MR “Eradication” or “Presumed Eradication”., Number of days of antibiotic usage., Number of days with MV., Number of days to discharge from ICU., Overall Survival: all-cause mortality, at FUp2.

Source: https://euclinicaltrials.eu/ctis-public/view/2025-521533-85-00